EU clinical trial 2023-506706-40-00: GLOASIS - A Phase II multicenter, open-label Study Evaluating Glofitamab in Combination With Venetoclax Plus Zanubrutinib Or Venetoclax alone in Subjects With Untreated Or Refractory high risk Mantle-Cell Lymphoma
Protocol code: MO44869_GLOASIS
Sponsor: Lymphoma Academic Research Organisation (Laboratory/Research/Testing facility). Phase: Phase II and Phase III (Integrated). Countries: Belgium (ongoing, recruiting), France (ongoing, recruiting).
Therapeutic area(s): Diseases [C] - Hemic and Lymphatic Diseases [C15]
Gender: Female, Male. Age: 18-64 years, 65+ years. Enrolment: 100.
Status: Ongoing, recruiting. Start date (EU): 2025-02-11. Decision date: 2024-07-22. Results received: No. Last updated: 2026-06-26.
Decision dates by country: BE: 2024-07-22, FR: 2024-07-22

Condition(s): Mantle-Cell Lymphoma
Product: VENETOCLAX, Columvi 10 mg concentrate for solution for infusion, VENETOCLAX, OBINUTUZUMAB, GLOFITAMAB, VENETOCLAX, ZANUBRUTINIB

Primary endpoint: The primary efficacy endpoint is the PFS at 12 months (end of C17) from first dose of study treatment as determined by imaging central review (Lugano 2014 criteria), Each cohort will be assessed independently.
Endpoint(s): Overall response rates (ORR) and complete response rates (CRR) as determined by investigator and by imaging central review,, PFS at 12 months (end of C17) from first dose of study treatment as determined by investigator (Lugano 2014 criteria). Each cohort will be assessed independently., Duration of response (DOR) according to investigator,, Event-free survival (EFS) according to investigator, Disease-free survival (DFS) according to investigator,, Overall survival (OS),, Time to next anti-lymphoma treatment (TTNT),, Safety and tolerability,, MRD response in peripheral blood,

Source: https://euclinicaltrials.eu/ctis-public/view/2023-506706-40-00